EU clinical trial 2024-518775-54-00: Utvärdering av två kortison behandlingsstrategier hos patienter med nydiagnostiserad, tidigare obehandlad reumatoid artrit: en randomiserad, öppen, non-inferiority, klinisk studie (OPRERA)
Protocol code: OPRERA
Sponsor: Karolinska University Hospital (Hospital/Clinic/Other health care facility). Phase: Therapeutic use (Phase IV). Countries: Sweden (ongoing, recruiting).
Therapeutic area(s): Diseases [C] - Immune System Diseases [C20]
Gender: Female, Male. Age: 18-64 years, 65+ years. Enrolment: 166.
Status: Ongoing, recruiting. Start date (EU): 2021-10-05. Decision date: 2024-10-28. Results received: No. Last updated: 2025-10-01.

Condition(s): Rheumatoid arthritis
Product: Prednisolon Pfizer 2,5 mg tabletter, Prednisolon Pfizer 5 mg tabletter

Primary endpoint: Klinisk effektivitet definierat som time-averaged DAS28 vid månad 12
Endpoint(s): Andel patienter med radiografisk progression av artritförändringar vid månad 12 och 24 jämfört med baseline. Radiografisk progression baseras på radiologens bedömning, och det inkluderar nytillkomna usurer och/eller periartikulär osteoporos och/eller ledbroskreduktion., Förbättring av smärta baserad påVAS smärta (0-10cm) vid månad 6, 12 och 24., Förbättring av funktionsförmåga baserad på HAQ vid månad 6, 12 och 24., Förbättring av livskvalitet baserad på EQ5D vid månad 6, 12 och 24., Förbättring av trötthet baserad på VAS trötthet (0-10cm) vid månad 6, 12 och 24., Förbättring av allmänhälsa enligt VAS allmänhälsa (0-10cm) vid månad 6, 12 och 24., Säkerhet (AEs och SAEs) under studiens duration (2 år)., Andel patienter som behövde intensifiering av behandling med tillägg av en bDMARD på grund av ineffektivitet vid månad 12 och månad 24.

Source: https://euclinicaltrials.eu/ctis-public/view/2024-518775-54-00